EU clinical trial 2022-501554-11-00: FILOCLL015 - GLORIFY - A phase 2 study evaluating the bispecific CD3xCD20 antibody GLOfitamab in combination with rituximab or obinutuzumab plus cyclophosphamide, doxorubicin, vincristine and prednisone (CHOP) in patients with RIchter syndrome as Frontline therapY
Sponsor: French Innovative Leukemia Organization (Laboratory/Research/Testing facility). Phase: Therapeutic exploratory (Phase II). Countries: France (ongoing, recruiting).
Therapeutic area(s): Diseases [C] - Hemic and Lymphatic Diseases [C15]
Gender: Female, Male. Age: 18-64 years, 65+ years. Enrolment: 40.
Status: Ongoing, recruiting. Start date (EU): 2024-03-21. Decision date: 2023-08-28. Results received: No. Last updated: 2026-07-09.

Condition(s): Patients with previously untreated Richter’s syndrome (RS), defined as the transformation of chronic lymphocytic leukemia (CLL) into high-grade lymphoma of diffuse large B-cell lymphoma (DLBCL) histology.
Product: CORTANCYL 20 mg, comprimé sécable, Glofitamab, Gazyvaro 1,000 mg concentrate for solution for infusion., Rixathon 100 mg concentrate for solution for infusion, ENDOXAN 1000 mg, poudre pour solution injectable, ONCOVIN 1 mg, solution injectable, Columvi 10 mg concentrate for solution for infusion, DOXORUBICINE ACCORD 2 mg/ml, solution pour perfusion

Primary endpoint: Percentage of participants with a complete metabolic response (CMR) as assessed by the investigator using the Cheson IWG 2014 Lugano Classification (i.e. Deauville scale 1-3)50 after 6 cyles of R/G-CHOP or at permanent treatment discontinuation. End of treatment is defined as after 6 cycles of R/G-CHOP + glofitamab. Permanent treatment discontinuation is defined as the discontinuation of all treatments (R/G-CHOP, glofitamab).
Endpoint(s): • Toxicity according to the CTCAE v.5 and ASTCT Consensus grading for ICANS and CRS, • Overall response rate (ORR) according to Cheson IWG 2014 Lugano Classification (i.e. Deauville scale 1-3) after 4 and 6 cycles, • CR rate after 4 and 6 cycles according to Cheson IWG 2014 Lugano Classification (i.e. Deauville scale 1-3), • Progression free survival (PFS), • Time to next treatment (TTNT), • Response duration • Response regarding CLL according to the iwCLL 2018 criteria • Overall survival • Causes of death

Source: https://euclinicaltrials.eu/ctis-public/view/2022-501554-11-00